EU clinical trial 2023-505514-15-00: Randomized phase III trial investigating the survival benefit of adding thoracic radiotherapy to durvalumab (MEDI4736) immunotherapy plus chemotherapy in extensive stage small-cell lung cancer
Sponsor: Norwegian University Of Science And Technolology (Educational Institution). Phase: Therapeutic confirmatory (Phase III). Countries: Netherlands (ongoing, recruitment ended), Norway (ongoing, recruitment ended), Iceland (ongoing, recruitment ended), Estonia (ongoing, recruitment ended), Sweden (ongoing, recruitment ended).
Therapeutic area(s): Diseases [C] - Neoplasms [C04]
Gender: Female, Male. Age: 18-64 years, 65+ years. Enrolment: 310.
Status: Ongoing, recruitment ended. Start date (EU): 2022-01-11. Decision date: 2023-11-29. Results received: No. Last updated: 2025-09-04.
Decision dates by country: IS: 2023-12-05, EE: 2023-12-04, NL: 2023-11-29, SE: 2023-11-29, NO: 2023-11-30

Condition(s): Small-cell lung cancer, extensive stage
Product: IMFINZI 50 mg/mL concentrate for solution for infusion.

Primary endpoint: 1-year overall survival
Endpoint(s): 2-year, 3-year, 4-year and 5-year overall survival, Overall response rates, Response rates in non-irradiated lesions, Progression free survival, Progression free survival in non-irradiated lesions, Local control rates in the thorax, Frequency and severity of adverse events, Health-related quality of life

Source: https://euclinicaltrials.eu/ctis-public/view/2023-505514-15-00